EU clinical trial 2024-513086-39-00: A Long-term Follow-up Study of Patients in the Clinical Trials for Spinal Muscular Atrophy Receiving AVXS-101
Protocol code: AVXS-101-LT-002
Sponsor: Novartis Pharma AG (Pharmaceutical company). Phase: Therapeutic confirmatory (Phase III). Countries: Belgium (ongoing, recruitment ended), France (ongoing, recruitment ended), Italy (ongoing, recruitment ended).
Therapeutic area(s): Diseases [C] - Nervous System Diseases [C10]
Gender: Female, Male. Age: 0-17 years, 18-64 years. Enrolment: 22.
Status: Ongoing, recruitment ended. Start date (EU): 2020-06-16. Decision date: 2024-06-26. Results received: No. Last updated: 2026-06-18.
Decision dates by country: FR: 2024-07-25, BE: 2024-06-26, IT: 2024-07-02

Condition(s): Spinal Muscular Atrophy
Product: Zolgensma 2 × 10^13 vector genomes/mL solution for infusion

Primary endpoint: Number of participants who reach developmental milestones, Change from baseline in Hammersmith Functional Motor Scale - Expanded (HFMSE) score, Change from baseline in Revised Upper Limb Module (RULM), Change from baseline in Bayley Scales of Infant and Toddler Development (Bayley-III), Change from baseline in Cogstate Computerized Cognitive Battery, Change from baseline in Clinical Evaluation of Language Fundamentals (CELF-5), Change from baseline in Assessment of Caregiver Experience with Neuromuscular Disease (ACEND), Number of participants who experience a clinically significant change from baseline in pulmonary assessment results and require ventilatory support, Number of participants who experience swallowing dysfunction and require nutritional support, Number of participants who experience a clinically significant change from baseline in physical examination findings, Number of participants who experience a clinically significant change from baseline in vital signs measurements, Change from baseline in height measurements, Change from baseline in weight measurements, Number of participants who experience a clinically significant change from baseline in clinical laboratory assessments, Number of participants who experience a clinically significant change from baseline in cardiac assessments, Number of participants who experience a clinically significant change from baseline in observational phase questionnaire results, Concomitant Medications, Any other treatment for SMA for the observational phase, Number of participants who experience at least one serious adverse event (SAE), Number of participants who experience at least one adverse event of special interest (AESI)

Source: https://euclinicaltrials.eu/ctis-public/view/2024-513086-39-00